EU clinical trial 2024-519128-26-00: A phase 2, double-masked, randomized, multicenter, parallel group, placebo-controlled study to investigate the efficacy and safety of GAL-101, 2%, ophthalmic solution in patients with non-foveal geographic atrophy secondary to non-neovascular age-related macular degeneration: eDREAM study
Protocol code: GAL-101-C0201
Sponsor: Galimedix Therapeutics Inc. (Pharmaceutical company). Phase: Therapeutic exploratory (Phase II). Countries: Ireland (ongoing, recruiting), Germany (ongoing, recruiting), Italy (authorised, recruiting), France (authorised, recruiting).
Therapeutic area(s): Diseases [C] - Eye Diseases [C11]
Gender: Female, Male. Age: 18-64 years. Enrolment: 65.
Start date (EU): 2025-05-22. Decision date: 2025-04-04. Results received: No. Last updated: 2026-07-22.
Decision dates by country: IT: 2025-10-02, IE: 2025-04-04, FR: 2025-10-22, DE: 2025-09-10

Condition(s): Non-foveal geographic atrophy secondary to non-neovascular age-related macular degeneration
Product: GAL-101 ophtalmic solution matching placebo. It contains the excipients as GAL-101 ophtalmic solution plus Sodium Chloride instead of the API, which allows to achieve the same osmolarity as GAL-101 ophtalmic solution, GAL-101 salt

Primary endpoint: Comparision between groups of annual rate of change in the area of GA as measured by fundus autofluorescence (FAF) (Baseline to last on-treatment visit)
Endpoint(s): Comparision between groups of annual rate of change in the area of PRD as measured by optical coherence tomography (OCT) (Baseline to last on-treatment visit), Comparison between groups of annual rate of change in mean sensitivity of all grid points, excluding the 5 points inside the GA lesion and the 5 points fixed in the fovea, using mesopic microperimetry (MP) (Baseline to last on-treatment visit)

Source: https://euclinicaltrials.eu/ctis-public/view/2024-519128-26-00